EU clinical trial 2023-508634-34-00: Interventional, multicenter, open-label, randomized, non-comparative trial evaluating the safety, in terms of HBV virological control, of 2 antiviral treatment relief strategies, in patients co-infected with the HIV-1 and HBV viruses
Protocol code: ANRS0250s-BI-LIGHT
Sponsor: Inserm (Laboratory/Research/Testing facility). Phase: Therapeutic exploratory (Phase II). Countries: France (ongoing, recruiting).
Therapeutic area(s): Diseases [C] - Pathological Conditions, Signs and Symptoms [C23]; Diseases [C] - Virus Diseases [C02]; Diseases [C] - Immune System Diseases [C20]
Gender: Female, Male. Age: 18-64 years. Enrolment: 140.
Status: Ongoing, recruiting. Start date (EU): 2025-05-14. Decision date: 2024-03-22. Results received: No. Last updated: 2026-07-21.
Decision dates by country: FR: 2024-06-12

Condition(s): co-infected with the HIV-1 and HBV viruses
Product: PREZISTA 800 mg film-coated tablets, Tivicay 50 mg film-coated tablets, Epivir 300 mg film-coated tablets, Norvir 100 mg powder for oral suspension

Primary endpoint: The primary endpoint was the proportion of participants with HBV virological failure at 96 weeks. Failure was defined as two successive HBV viral load measurements >10 IU/mL or one HBV viral load measurement above the detection threshold followed by permanent discontinuation of the strategy or follow-up in the trial.
Endpoint(s): • HBV virological success rate at 48 weeks, • HIV virological success rate at 48 and 96 weeks, • Time to virological failure (rebound HBV and/or HIV viral load), • The rate of participants with at least one HBV viral load blip until S48 and until S96, • Selection of HBV resistance mutations at the time of virological failure, • Incidence of grade 3 or higher adverse events of grade 3 or higher, incidence of adverse events and incidence of strategy discontinuation of the strategy at W48 and W96, • Evolution of CD4 and CD8 T lymphocytes, and the CD4/CD8 ratio from W0 to W48 and W96, • Evolution of metabolic parameters (total cholesterol, LDL-c, HDL-c, triglycerides and fasting blood sugar) from W0 to W48 and W96, • Participants' compliance with treatment (self-questionnaire) at S0, S12, S24, S48, S72 and S96, • Participants' quality of life using the Pro-Qol self-questionnaire at S0, S12, S24, S48, S72 and S96, HBV virological success rate at 96 weeks between arms

Source: https://euclinicaltrials.eu/ctis-public/view/2023-508634-34-00